EU clinical trial 2025-520800-81-00: THE EFFECT OF ROPINIROLE ON FUNCTIONAL CONNECTIVITY AND METACOGNITION IN HEALTHY SUBJECTS
Protocol code: UnaWireD-ROP
Sponsor: Universita' Degli Studi Di Modena E Reggio Emilia (Educational Institution). Phase: Phase II and Phase III (Integrated). Countries: Italy (authorised, recruitment pending).
Therapeutic area(s): Phenomena and Processes [G] - Biological Phenomena [G16]; Psychiatry and Psychology [F] - Behavior and Behavior Mechanisms [F01]; Psychiatry and Psychology [F] - Behavioral Disciplines and Activities [F04]; Phenomena and Processes [G] - Mathematical Concepts [G17]
Gender: Male. Age: 18-64 years. Enrolment: 20.
Status: Authorised, recruitment pending. Decision date: 2025-12-10. Results received: No. Last updated: 2025-12-10.

Condition(s): Healthy volunteers (mechanistic study evaluating the effect of a single oral dose of ropinirole 1 mg on metacognition and resting‑state functional brain connectivity. Product has MA and has been shown to be safe in humans)
Product: placebo, Requip 1 mg compresse rivestite con film

Primary endpoint: The primary endpoint will be the within-participant change in metacognitive efficiency (M-ratio; meta-d'/d') under ropinirole 1 mg versus placebo, estimated from confidence ratings on cognitive testing. It will be derived from trial-wise accuracy and confidence ratings on a modified version of the Rey Auditory-Verbal Learning Test, and computed using a signal-detection-theoretic framework, which separates metacognitive sensitivity from task performance
Endpoint(s): Secondary endpoints will be pre-specified seed-to-seed connectivity measures from Resting-state fMRI (rs-fMRI) data specifically targeting the Default Mode Network (DMN) and Salience Network (SN).

Source: https://euclinicaltrials.eu/ctis-public/view/2025-520800-81-00